EU clinical trial 2023-509590-23-00: Phase 3b, Open-label, Multicenter, Single-dose Study Investigating Efficacy and Safety of CSL222 (Etranacogene Dezaparvovec) Gene Therapy Administered to Adult Subjects with Severe or Moderately Severe Hemophilia B with Detectable Pretreatment AAV5 Neutralizing Antibodies.
Protocol code: CSL222_3005
Sponsor: CSL Behring LLC (Pharmaceutical company). Phase: Therapeutic confirmatory (Phase III). Countries: Poland (authorised, recruitment pending), Bulgaria (authorised, recruiting).
Therapeutic area(s): Diseases [C] - Hemic and Lymphatic Diseases [C15]
Gender: Female, Male. Age: 18-64 years, 65+ years. Enrolment: 3.
Start date (EU): 2026-04-22. Decision date: 2025-01-27. Results received: No. Last updated: 2026-02-16.
Decision dates by country: PL: 2025-01-27, BG: 2025-01-27

Condition(s): Hemophilia B
Product: Hemgenix 1x10^13 genome copies/mL concentrate for solution for infusion

Primary endpoint: Annualized bleeding rate (ABR)
Endpoint(s): 1) Number of participants with Treatment Emergent Adverse Events (TEAEs)., 2) Percentage of participants with TEAEs., 3) Number of TEAEs., 4) Change in Liver ultrasound., 5) Number of participants who develop Factor IX (FIX) Inhibitors., 6) Percentage of participants who develop Factor IX (FIX) Inhibitors., 7) Change in hematology and biochemistry parameters., 8) Number of participants with clinically significant increase in Alanine Aminotransferase (ALT) or Aspartate Aminotransferase (AST)., 9) Percentage of participants with clinically significant increase in ALT or AST., 10) Corticosteroid use for ALT or AST increases after CSL222 treatment., 11) Number of participants with clinically significant Alpha-fetoprotein (AFP)., 12) Percentage of participants with clinically significant AFP., 13) Number of participants with infusion related reactions or hypersensitivity reactions., 14) Percentage of participants with infusion related reactions or hypersensitivity reactions., 15) Change in the Uncontaminated Endogenous FIX activity., 16)Annualized consumption of FIX replacement therapy., 17) Annualized infusion rate of FIX replacement therapy., 18) Number of participants remaining free of continuous routine FIX prophylaxis., 19) Percentage of participants remaining free of continuous FIX prophylaxis., 20) ABR for spontaneous bleeding episodes., 21) ABR for joint bleeding episodes., 22) ABR for FIX-treated bleeding episodes., 23) Correlation analysis of FIX activity levels with baseline AAV5 NAb titers., 24) Number of participants with new target joints and resolved preexisting target joints., 25) Number of participants with zero bleeding episodes and zero FIX-treated bleeding episodes ., 26) Percentage of participants with zero bleeding episodes and zero FIX-treated bleeding episodes, 27) Change in the EuroQol-5 Dimensions-5 Levels (EQ-5D-5L) Visual Analogue Scale (VAS) Overall Score., 28) Change in the EQ-5D-5L Index Scores., 29) Number of paticipant with Uncontaminated Endogenous FIX Activity of greater than or equal to >=5%, 30) Percentage of participant with Uncontaminated Endogenous FIX Activity of >=5%

Source: https://euclinicaltrials.eu/ctis-public/view/2023-509590-23-00